EU clinical trial 2024-515919-22-00: A Phase 3 Randomized, Open-Label Study to Evaluate the Efficacy and Safety of Tobevibart+Elebsiran Combination Therapy in Participants with Chronic HDV Infection (ECLIPSE 1)
Protocol code: VIR-CHDV-V203
Sponsor: Vir Biotechnology Inc. (Pharmaceutical company). Phase: Therapeutic confirmatory (Phase III). Countries: Romania (ongoing, recruitment ended), France (ended), Germany (ongoing, recruitment ended).
Therapeutic area(s): Diseases [C] - Virus Diseases [C02]
Gender: Female, Male. Age: 18-64 years, 65+ years. Enrolment: 27.
Start date (EU): 2025-06-02. Decision date: 2025-05-12. Results received: No. Last updated: 2025-11-24.
Decision dates by country: RO: 2025-05-19, DE: 2025-05-12, FR: 2025-05-19

Condition(s): Chronic Hepatitis D Virus (HDV) Infection
Product: VIR-3434, VIR-2218

Primary endpoint: HDV RNA < LLOQ (lower limit of quantification), TND (target not detected) and ALT (alanine aminotransferase) normalization (ALT ≤ ULN) at Week 48 for Arm 1 vs at Week 12 for Arm 2., Primary safety Incidence of TEAEs and SAEs through Week 12.
Endpoint(s): • HDV RNA < LLOQ, TND at Week 48 for Arm 1 vs at Week 12 for Arm 2 (key secondary endpoint). • HDV RNA < LLOQ at Week 48 for Arm 1 vs at Week 12 for Arm 2. • Change from baseline in HDV RNA at Week 48 for Arm 1 vs at Week 12 for Arm 2, • ALT ≤ ULN at Week 48 for Arm 1 vs at Week 12 for Arm 2 • ALT < 1.25 × ULN at Week 48 for Arm 1 vs at Week 12 for Arm 2 • Change from baseline in ALT at Week 48 for Arm 1 vs at Week 12 for Arm 2, • HDV RNA < LLOQ, TND and ALT < 1.25 × ULN at Week 48 for Arm 1 vs at Week 12 for Arm 2, • HDV RNA < LLOQ, TND and ALT ≤ ULN at 48, 96, 144, 192 and 240 weeks of tobevibart + elebsiran treatment • HDV RNA < LLOQ and ALT ≤ ULN at 48, 96, 144, 192 and 240 weeks of tobevibart + elebsiran treatment • HDV RNA < LLOQ, TND and ALT < 1.25 × ULN at 48, 96, 144, 192 and 240 weeks of tobevibart + elebsiran treatment, • HDV RNA < LLOQ, TND at 48, 96, 144, 192 and 240 weeks of tobevibart + elebsiran treatment • HDV RNA < LLOQ at 48, 96, 144, 192 and 240 weeks of tobevibart + elebsiran treatment • Change from baseline in HDV RNA at 48, 96, 144, 192 and 240 weeks of tobevibart + elebsiran treatment, • ALT ≤ ULN at 48, 96, 144, 192 and 240 weeks of tobevibart + elebsiran treatment • ALT < 1.25 × ULN at 48, 96, 144, 192 and 240 weeks of tobevibart + elebsiran treatment • Change from baseline in ALT at 48, 96, 144, 192 and 240 weeks of tobevibart + elebsiran treatment, Change from baseline in liver stiffness as measured by liver elastography at 48, 96,144, 192 and 240 weeks of tobevibart + elebsiran treatment, • Incidence of decompensated cirrhosis (clinical event or CPT score ≥ 7) by 48, 96, 144, 192and 240 weeks of tobevibart + elebsiran treatment • Incidence of HCC and progression to liver failure requiring transplantation or resulting in death by 48, 96. 144, 192 and 240 weeks of tobevibart + elebsiran treatment., Secondary safety: Incidence of TEAEs and SAEs through 48, 96, 144, 192and 240 weeks of treatment

Source: https://euclinicaltrials.eu/ctis-public/view/2024-515919-22-00